EU clinical trial 2022-501601-12-00: A Phase 2 Open-label Study of Loncastuximab Tesirine in Combination with Rituximab (Lonca-R) in Previously Untreated Unfit/Frail Patients with Diffuse Large B-cell Lymphoma (DLBCL) (LOTIS-9)
Protocol code: ADCT-402-203
Sponsor: ADC Therapeutics S.A. (Pharmaceutical company). Phase: Therapeutic exploratory (Phase II). Countries: Italy (ended), Spain (ended).
Therapeutic area(s): Diseases [C] - Neoplasms [C04]
Gender: Female, Male. Age: 65+ years. Enrolment: 28.
Status: Ended. Start date (EU): 2023-05-22. End date (EU): 2023-11-28. End date: 2024-01-22. Decision date: 2023-02-27. Results received: Yes. Last updated: 2023-10-25.
Decision dates by country: IT: 2023-03-01, ES: 2023-05-08

Condition(s): Diffuse large B-cell Lymphoma
Product: Loncastuximab Tesirine, Truxima 500 mg concentrate for solution for infusion, Truxima 100 mg concentrate for solution for infusion

Primary endpoint: Cohort A • CR rate defined as proportion of patients with a BOR of CR according to the 2014 Lugano Classification criteria, Cohort B • CR rate defined as proportion of patients with a BOR of CR according to the 2014 Lugano Classification criteria, Cohort B • Tolerability as defined by the percentage of patients completing a total of 4 cycles of therapy divided by the total number of patients.
Endpoint(s): ORR according to the 2014 Lugano Classification defined as the proportion of patients with a BOR of CR or PR., 2 year PFS, defined as the proportion of patients that are PFS event-free at 2 years, 3 year overall survival (3-yr OS), defined as the proportion of patients that are OS event-free at 3 years., Duration of response (DoR) defined as the time from the first documentation of tumor response (CR or PR) to disease progression or death, Frequency and severity of adverse events (AEs) and serious adverse events (SAEs), Changes from baseline in safety laboratory variables, vital signs, physical examinations, Eastern Cooperative Oncology Group scale of performance status (ECOG PS), Concentrations and PK parameters of loncastuximab tesirine pyrrolobenzodiazepine (PBD)-conjugated antibody, total antibody, and SG3199 unconjugated warhead, Frequency of confirmed positive anti-drug antibody (ADA) responses, their associated titers and, if applicable, neutralizing activity to loncastuximab tesirine after treatment with loncastuximab tesirine when given in combination with rituximab, Changes in patient-reported outcomes (e.g., symptoms, functions, and overall health status) from baseline as evaluated by Functional Assessment of Cancer Therapy - Lymphoma (FACT-Lym)

Source: https://euclinicaltrials.eu/ctis-public/view/2022-501601-12-00